EU clinical trial 2023-507573-17-01: AP-01 i.v. as add-on treatment for acute heart failure NYHA ≥ III A mono-center, randomized double-blind, placebo-controlled study AP-01 Heart Failure (AHF) Study
Protocol code: AP01-201
Sponsor: Ananda Pharma GmbH (Pharmaceutical company). Phase: Therapeutic exploratory (Phase II). Countries: Germany (not authorised).
Therapeutic area(s): Diseases [C] - Cardiovascular Diseases [C14]
Gender: Female, Male. Age: 18-64 years, 65+ years. Enrolment: 40.
Status: Not authorised. Decision date: 2024-03-04. Results received: No. Last updated: 2024-03-04.

Condition(s): Acute Heart Failure
Product: G-STROPHANTHIN, The placebo vial contains NaCl 0.9% and phosphate buffer ad 1ml corresponding to the IMP except API for intravenous administration. There are no visible differences in comparison to volume, seize, exterior, colour etc. of the investigational product.

Primary endpoint: Reduction of lactate during 90 minutes after first dose, reported as area under the curve. Reduction of NT-proBNP 72 hours after first dose.
Endpoint(s): Symptomatic and clinical improvement: a) Echocardiography (Visit 1 compared to Visit 6) b) Kansas City Cardiomyopathy Questionnaire (KCCQ-23): Visit 1 compared to Visit 10 and 11. Symptomatic and clinical improvement: Outcome differences NYHA III compared to NYHA IV, Duration of hospital stay, Mortality and Rate of Re-Hospitalisation

Source: https://euclinicaltrials.eu/ctis-public/view/2023-507573-17-01